EU clinical trial 2022-502981-26-00: A Study to Evaluate the Safety, Tolerability, and Pharmacokinetics of Multiple-Ascending Doses of RO7303509 in Patients with Systemic Sclerosis
Protocol code: GA43360
Sponsor: Genentech Inc. (Pharmaceutical company). Phase: Human Pharmacology (Phase I)- Other. Countries: Germany (ended), Belgium (ended), France (ended), Spain (ended), Portugal (ended), Poland (ended).
Therapeutic area(s): Phenomena and Processes [G] - Physical Phenomena [G01]; Diseases [C] - Immune System Diseases [C20]; Diseases [C] - Skin and Connective Tissue Diseases [C17]; Diseases [C] - Respiratory Tract Diseases [C08]; Phenomena and Processes [G] - Immune System Phenomena [G13]
Gender: Female, Male. Age: 18-64 years, 65+ years. Enrolment: 52.
Status: Ended. Start date (EU): 2022-06-27. End date (EU): 2025-07-08. End date: 2025-07-11. Decision date: 2024-02-19. Results received: No. Last updated: 2025-03-27.
Decision dates by country: DE: 2024-02-26, PT: 2024-02-19, PL: 2024-02-29, FR: 2024-03-06, ES: 2024-02-19, BE: 2024-02-23

Condition(s): Systemic Sclerosis

Source: https://euclinicaltrials.eu/ctis-public/view/2022-502981-26-00